EU clinical trial 2024-515304-39-00: A Long-Term follow-up Study to evaluate safety and tolerability of olipudase alfa in patients who completed the DFI12712 or the LTS13632 Study in France - PTA17397
Protocol code: PTA17397
Sponsor: Sanofi Winthrop Industrie (Pharmaceutical company). Phase: Therapeutic exploratory (Phase II). Countries: France (ended).
Therapeutic area(s): Diseases [C] - Congenital, Hereditary, and Neonatal Diseases and Abnormalities [C16]
Gender: Female, Male. Age: 0-17 years, 18-64 years. Enrolment: 3.
Status: Ended. Start date (EU): 2021-11-18. End date (EU): 2025-04-08. Decision date: 2024-08-02. Results received: Yes. Last updated: 2024-08-02.

Condition(s): Niemann-Pick disease
Product: Xenpozyme (olipudase alfa,GZ402665)

Primary endpoint: Number of adverse events (AEs) / serious adverse events (SAEs)

Source: https://euclinicaltrials.eu/ctis-public/view/2024-515304-39-00